EU clinical trial 2024-514612-27-01: Randomized controlled trial comparing clinical outcomes of Instant MSC Product accompanying Autologous Chondron Transplantation (IMPACT) for focal articular cartilage lesions of the knee to conservative treatment
Sponsor: Universitair Medisch Centrum Utrecht (Hospital/Clinic/Other health care facility). Phase: Therapeutic confirmatory (Phase III). Countries: Netherlands (ended).
Therapeutic area(s): Diseases [C] - Musculoskeletal Diseases [C05]
Gender: Female, Male. Age: 18-64 years. Enrolment: 60.
Status: Ended. Start date (EU): 2024-12-01. End date (EU): 2025-08-21. Decision date: 2024-11-27. Results received: No. Last updated: 2024-11-27.

Condition(s): Symptomatic articular cartilage lesion of the knee (femoral condyles or trochlea)
Product: Instant MSC Product accompanying Autologous Chondron Transplantation (IMPACT)

Primary endpoint: The primary study parameter will be the clinical improvement and quality of life after 3, 6 and 9 months as measured with, subscales of, the KOOS and the EQ5D, respectively
Endpoint(s): The secondary objective of this study is to examine parameters of structural repair 6 and 18 months after treatment. This will be assessed using MRI-scans.

Source: https://euclinicaltrials.eu/ctis-public/view/2024-514612-27-01